EU clinical trial 2025-523840-11-00: SETRAPED : A prospective, multicenter study evaluating the efficacy and tolerance of transmucosal midazolam for proportionate palliative sedation in children with refractory symptoms
Protocol code: ET25-085
Sponsor: Centre Leon Berard (Hospital/Clinic/Other health care facility). Phase: Therapeutic exploratory (Phase II). Countries: France (authorised, recruitment pending).
Therapeutic area(s): Diseases [C] - Pathological Conditions, Signs and Symptoms [C23]; Analytical, Diagnostic and Therapeutic Techniques and Equipment [E] - Therapeutics [E02]
Gender: Female, Male. Age: 0-17 years. Enrolment: 50.
Status: Authorised, recruitment pending. Decision date: 2026-07-17. Results received: No. Last updated: 2026-07-17.

Condition(s): Children with refractory symptoms
Product: MIDAZOLAM

Primary endpoint: To describe the efficacy of proportional sedation using transmucosal midazolam in pediatric palliative patients presenting with refractory symptoms

Source: https://euclinicaltrials.eu/ctis-public/view/2025-523840-11-00